EU clinical trial 2023-504434-22-00: A Randomized, Double-blind, Multi-center, Phase III Study of AK112 or Placebo Combined With Pemetrexed and Carboplatin in Patients With EGFR-mutant Locally Advanced or Metastatic Non-squamous NSCLC Who Have Failed to EGFR-TKI Treatment (HARMONi)
Protocol code: AK112-301
Sponsor: Summit Therapeutics Inc. (Pharmaceutical company). Phase: Therapeutic confirmatory (Phase III). Countries: Spain (ended), Italy (ongoing, recruitment ended), France (ongoing, recruitment ended).
Therapeutic area(s): Diseases [C] - Neoplasms [C04]
Gender: Female, Male. Age: 18-64 years, 65+ years. Enrolment: 45.
Start date (EU): 2023-10-03. Decision date: 2023-07-24. Results received: No. Last updated: 2026-03-27.
Decision dates by country: FR: 2023-10-26, IT: 2023-07-27, ES: 2023-07-24

Condition(s): Patients With EGFR-mutant Locally Advanced or Metastatic Non-squamous NSCLC Who Have Failed to EGFR-TKI Treatment
Product: ALIMTA 100 mg powder for concentrate for solution for infusion, Pemetrexed Sandoz 1000 mg powder for concentrate for solution for infusion, Carboplatino Pharmacia 10 mg/ml concentrado para solución para perfusión EFG, Carboplatino Teva 10 mg/ml Concentrado para solución para perfusión, Carboplatino Accord 10 mg/ml concentrado para solución para perfusión EFG, Pemetrexed Pfizer 1,000 mg powder for concentrate for solution for infusion, Pemetrexed Aurovit 25 mg/ml concentrado para solución para perfusión, ALIMTA 500 mg powder for concentrate for solution for infusion, Pemetrexed Pfizer 100 mg powder for concentrate for solution for infusion, Pemetrexed Sandoz 500 mg Powder for concentrate for solution for infusion, Carboplatino Accord 10 mg/ml concentrado para solución para perfusión EFG, Pemetrexed Sandoz 100 mg Powder for concentrate for solution for infusion, Pemetrexed Accord 100 mg powder for concentrate for solution for infusion., Pemetrexed Ever Pharma 25 mg/ml concentrado para solución para perfusion., Placebo to match AK112 (Ivonescimab) concentrate for solution for infusion. 10 mg/mL, 10 mL vial, Carboplatino Pharmacia 10 mg/ml concentrado para solución para perfusión EFG, Pemetrexed Accord 500 mg powder for concentrate for solution for infusion., ivonescimab, Pemetrexed Pfizer 500 mg powder for concentrate for solution for infusion, Pemetrexed Accord 1000 mg powder for concentrate for solution for infusion.

Primary endpoint: OS in the mITT population, PFS assessed by IRRC based on RECIST v1.1 in the mITT population
Endpoint(s): ORR (including DoR) assessed by IRRC based on RECIST v1.1 in the mITT Population, Safety assessment: incidence and severity of adverse events (AEs), clinically significant abnormal laboratory test results, PK characteristics: AK112 serum drug concentration at different time points after AK112 administration, Immunogenicity assessment: number and percentage of patients with detectable anti-AK112 antibody (ADA).

Source: https://euclinicaltrials.eu/ctis-public/view/2023-504434-22-00